EU clinical trial 2024-511609-44-00: Multicentric Phase II-III study evaluating the tailored management of locally-advanced rectal carcinoma after a favorable response to Induction chemotherapy
Protocol code: PROICM 2021-01 GRE
Sponsor: Institut Regional Du Cancer De Montpellier (Hospital/Clinic/Other health care facility). Phase: Phase II and Phase III (Integrated). Countries: France (ongoing, recruiting).
Therapeutic area(s): Diseases [C] - Neoplasms [C04]
Gender: Female, Male. Age: 18-64 years, 65+ years. Enrolment: 430.
Status: Ongoing, recruiting. Start date (EU): 2022-02-03. Decision date: 2024-04-09. Results received: No. Last updated: 2025-02-27.

Condition(s): Rectum cancer
Product: IRINOTECAN HYDROCHLORIDE, CAPECITABINE, OXALIPLATIN, CAPECITABINE, CALCIUM FOLINATE, FLUOROURACIL

Primary endpoint: Phase II : The primary endpoint is the R0 resection rate (R0 is a Circumferential resection margin (CRM) ≥1 mm)., Phase III: The primary endpoint is the 3 year-DFS.
Endpoint(s): The compliance rate of the therapeutic schedule, Sphincter saving surgery rate, Pathological complete response rate, Dworak Grading, Rates of TME grading (Quirke), Distal margin (DM), Neoadjuvant rectal Score, 2-3 year Local recurrence rate using the time to local recurrence (TLR) defined as the time interval from the date of randomization to the date of local recurrence. Patients without local recurrence will be censored at the date of last follow-up or death., 2-3 year Metastasis recurrence rate using the time to metastasis defined as the time interval from the date of randomization to the date of metastasis. Patients without metastasis will be censored at the date of last follow-up or death., 3-year local recurrence free survival rate (L-RFS) defined as the time interval from the date of randomization to the date of local recurrence or death from any cause). Patients alive without local recurrence will be censored at the date of last follow-up., 3-year metastasis recurrence free survival rate (M-RFS defined as the time interval from the date of randomization to the date of metastatic recurrence or death from any cause). Patients alive without metastasis will be censored at the date of last follow-up., 3-year disease free survival rate (DFS) defined as the time interval from the date of randomization until the date of the first cancer-related event, or death from any cause). Patients alive without event will be censored at the date of last follow-up., 3 and 5-year Overall survival (OS) defined as the time interval from the date of randomization to the date of death from any cause. Patients alive will be censored at the date of last follow-up., Safety of neoadjuvant chemotherapy and radiochemotherapy will be evaluated using the NCI-CTCAE version 5.0 scale until the end of the post legal surgery period., Operative morbidity: Clavien-Dindo score (3 & 4), definitive stoma rate, second surgery rate, rehospitalization rate., Digestive: LARS syndrome (randomization, post-surgery, 4, , and 12 months after surgery,, Urinary and sexual function evaluated by questionnaires at randomization, post-surgery, 4 and 12 months after surgery, Quality of life evaluated by the EORTC QLQ-C30 + CR29 questionnaires (randomization, post-surgery, 4 and 12 months after surgery)

Source: https://euclinicaltrials.eu/ctis-public/view/2024-511609-44-00